EU clinical trial 2023-509155-14-00: C5691004 _ A dual-cohort, open-label, phase 2 study of brentuximab vedotin and CHP (A+CHP) in the frontline treatment of subjects with peripheral T-cell lymphoma (PTCL) with less than 10% CD30 expression
Protocol code: C5691004 / SGN35-032
Sponsor: Seagen Inc. (Pharmaceutical company). Phase: Therapeutic exploratory (Phase II). Countries: Spain (ended), Italy (ended), France (ended).
Therapeutic area(s): Diseases [C] - Neoplasms [C04]
Gender: Female, Male. Age: 18-64 years, 65+ years. Enrolment: 69.
Status: Ended. Start date (EU): 2021-06-10. End date (EU): 2026-01-05. End date: 2026-01-12. Decision date: 2023-12-15. Results received: No. Last updated: 2026-01-16.
Decision dates by country: FR: 2023-12-18, ES: 2023-12-15, IT: 2023-12-19

Condition(s): Peripheral T-cell Lymphoma
Product: Prednison 5 mg GALEN®, DOXORUBICINE ACCORD 2 mg/ml, solution pour perfusion, Prednison 50 mg GALEN®, Prednison 20 mg GALEN®, BRENTUXIMAB VEDOTIN, Prednison 10 mg GALEN®, Cyclophosphamide 500 mg Powder for Solution for Injection or Infusion

Primary endpoint: ORR per BICR following the completion of study treatment using Revised Response Criteria for Malignant Lymphoma criteria
Endpoint(s): Complete response rate per BICR, PFS per BICR, OS, DOR per BICR, ORR per BICR, using modified Lugano criteria, Type, incidence, severity, seriousness, and relatedness of adverse events, Laboratory abnormalities

Source: https://euclinicaltrials.eu/ctis-public/view/2023-509155-14-00